EU clinical trial 2024-516609-22-00: A Phase 3 Randomized, Double-Blinded, Placebo-Controlled Multicenter Trial with Open-Label Extension to Evaluate the Efficacy, Safety, and Tolerability of Efgartigimod PH20 Subcutaneous Administered by Prefilled Syringe in Adult Patients with Primary Sjögren’s Disease
Protocol code: ARGX-113-2306
Sponsor: Argenx (Pharmaceutical company). Phase: Therapeutic confirmatory (Phase III). Countries: Poland (ongoing, recruitment ended), Netherlands (ended), Italy (ongoing, recruitment ended), Lithuania (ongoing, recruitment ended), Romania (ongoing, recruitment ended), Austria (ended), Greece (ended), Spain (ongoing, recruitment ended), Germany (ongoing, recruitment ended), Slovakia (ongoing, recruitment ended), France (ongoing, recruitment ended), Estonia (ongoing, recruitment ended), Belgium (ongoing, recruitment ended), Sweden (ongoing, recruitment ended), Ireland (ended), Hungary (ongoing, recruitment ended), Bulgaria (ongoing, recruitment ended), Portugal (ongoing, recruitment ended).
Therapeutic area(s): Diseases [C] - Immune System Diseases [C20]
Gender: Female, Male. Age: 18-64 years, 65+ years. Enrolment: 248.
Start date (EU): 2025-04-15. Decision date: 2025-03-25. Results received: No. Last updated: 2026-05-11.
Decision dates by country: DE: 2025-03-26, EE: 2025-03-27, AT: 2025-03-31, LT: 2025-03-26, HU: 2025-03-28, SK: 2025-03-25, IE: 2025-03-28, IT: 2025-03-26, GR: 2025-03-28, SE: 2025-03-26, PT: 2025-03-31, NL: 2025-03-27, ES: 2025-03-26, FR: 2025-03-27, BG: 2025-03-28, PL: 2025-03-27, RO: 2025-03-31, BE: 2025-03-25

Condition(s): Primary Sjögren’s Disease
Product: Placebo matching IMP., Vyvgart 1 000 mg solution for injection in pre-filled syringe

Primary endpoint: Change from baseline in clinESSDAI score at week 48
Endpoint(s): Change from baseline in ESSDAI score at week 48, Proportion of participants with low disease activity (clinESSDAI < 5) at week 48, Proportion of responders on STAR (defined as ≥ 5 points) at week 48, Change from baseline in DiSSA joint pain item at week 48, Change from baseline in DiSSA total score at week 48, Change from baseline in DiSSA sicca domain at week 48, Proportion of participants with MCII (minimal clinically important improvement) in ESSDAI (defined as improvement of ≥ 3 points) at week 48, Change from baseline in clinESSDAI score at week 24

Source: https://euclinicaltrials.eu/ctis-public/view/2024-516609-22-00